EU clinical trial 2023-507700-32-00: Double-blind, randomized, placebo-controlled, pilot clinical trial to evaluate the safety, tolerability and efficacy of two doses of a conditioned medium from a co-culture of M2-macrophages and fat-derived mesenchymal cells (PRS CK STORM) in the modulation of the cytokine storm in patients with acute respiratory infection caused by SARS-Cov-2, influenza A, influenza B and respiratory syncytial virus (RSV)
Protocol code: PRSCK-21P01
Sponsor: Peaches Biotech S.L. (Hospital/Clinic/Other health care facility). Phase: Human Pharmacology (Phase I)- First administration to humans. Countries: Spain (ongoing, recruiting).
Therapeutic area(s): Diseases [C] - Virus Diseases [C02]
Gender: Female, Male. Age: 18-64 years, 65+ years. Enrolment: 50.
Status: Ongoing, recruiting. Start date (EU): 2024-10-02. Decision date: 2024-01-22. Results received: No. Last updated: 2026-05-13.

Condition(s): Acute respiratory distress syndrome (ARDS) caused by SARS-Cov-2, influenza A, influenza B and respiratory syncytial virus (RSV)

Source: https://euclinicaltrials.eu/ctis-public/view/2023-507700-32-00